EU clinical trial 2024-515857-93-00: Obinutuzumab for primary membranous nephropathy: a pilot study in patients with rituximab-resistant or rituximab-dependent nephrotic syndrome and in patients intolerant to rituximab (the ORION study)
Sponsor: Istituto Di Ricerche Farmacologiche Mario Negri (Laboratory/Research/Testing facility). Phase: Therapeutic exploratory (Phase II). Countries: Italy (ended).
Therapeutic area(s): Diseases [C] - Immune System Diseases [C20]
Gender: Female, Male. Age: 18-64 years, 65+ years. Enrolment: 20.
Status: Ended. Start date (EU): 2021-12-17. End date (EU): 2026-02-20. Decision date: 2024-10-16. Results received: No. Last updated: 2024-12-20.

Condition(s): Primary Membranous Nephropathy
Product: Trimeton 10 mg/1 ml soluzione iniettabile, OMNIPAQUE 300 mg I/ml soluzione iniettabile, Gazyvaro 1,000 mg concentrate for solution for infusion., TACHIPIRINA 500 mg compresse, MEDROL 16 mg compresse, CORTRIUM 40 mg/2 ml polvere e solvente per soluzione iniettabile

Primary endpoint: Incidence of complete or partial remission of nephrotic syndrome at 12 months from Obinutuzumab treatment in (1) Rituximab-Intolerant patients and (2) Rituximab-Resistant and Rituximab-Dependent patients considered separately and as a whole., Incidence of serious and non-serious adverse events (in particular, infusion-related reactions (IRRs)) during and after Obinutuzumab treatment in (1) Rituximab-Intolerant patients and (2) Rituximab-Resistant and Rituximab- Dependent patients considered separately and as a whole.
Endpoint(s): To evaluate, in the both cohorts, the incidence of complete or partial remission of nephrotic syndrome at 6 and 24 months from Obinutuzumab treatment., To evaluate, in the both cohorts, the incidence and time to nephrotic syndrome relapse in patients who previously achieved complete or partial remission during the study., To evaluate, in the both cohorts, the incidence and time to complete immunologic remission (defined as anti-PLA2R levels below the positivity threshold of the assay) in anti-PLA2R positive patients during the whole follow- up period., To evaluate, in the both cohorts, the change in proteinuria and serum anti-PLA2R antibody levels (in anti-PLA2R positive patients) considered as continuous variables at each time point during the follow-up as compared to baseline., To evaluate, in the both cohorts, the change in measured GFR, albumin and IgG fractional clearances at 6 and 12, 18 and 24 months from treatment as compared to baseline., To evaluate, in the both cohorts, the safety parameters including clinical and laboratory tests evaluated at each time point during the follow-up and any intercurrent serious and non-serious adverse event., To evaluate, in the both cohorts, the changes in peripheral leukocyte subpopulations (B, T, NK cells) and BAFF levels at every time point included in the study flow-chart., To evaluate, in both the cohorts, the changes in the number of podocytes lost in the urine (podocituria) evaluated at each time point, and relationships between podocituria and proteinuria or the number of glomerular podocytes in baseline and repeat, optional patients’ renal biopsies., To evaluate, in the both cohorts, patient health-related quality of life as measured by means of the SF-12 questionnaire.

Source: https://euclinicaltrials.eu/ctis-public/view/2024-515857-93-00